EU clinical trial 2023-507771-22-01: A Phase 3, Open-Label, Long-Term Safety Extension Study Evaluating the Safety and Tolerability of the Fixed-Dose Combination of Obeticholic Acid and Bezafibrate in Subjects with Primary Biliary Cholangitis
Protocol code: 977-311
Sponsor: Intercept Pharmaceuticals Inc. (Pharmaceutical company). Phase: Therapeutic confirmatory (Phase III). Countries: Netherlands (ended), France (ended), Norway (ended), Hungary (ended), Italy (ended), Lithuania (ended), Germany (ended), Czechia (ended), Croatia (ended), Estonia (ended), Belgium (ended), Greece (ended).
Therapeutic area(s): Diseases [C] - Digestive System Diseases [C06]
Gender: Female, Male. Age: 18-64 years, 65+ years. Enrolment: 53.
Status: Ended. Start date (EU): 2025-04-03. End date (EU): 2025-10-15. End date: 2025-10-21. Decision date: 2025-02-24. Results received: Yes. Last updated: 2025-10-13.
Decision dates by country: NL: 2025-02-24, FR: 2025-02-24, CZ: 2025-02-26, IT: 2025-02-26, LT: 2025-02-26, HU: 2025-02-26, HR: 2025-03-03, GR: 2025-02-25, EE: 2025-02-28, NO: 2025-02-24, BE: 2025-02-24, DE: 2025-02-25

Condition(s): Primary Biliary Cholangitis (PBC)
Product: OCA 5MG IR +BZF 400 MG SR

Primary endpoint: 1. Response rate of ≥40% reduction from baseline and normalization rates of ALP;, 2. normalization rates of GGT, ALT, AST, total and conjugated bilirubin;, 3. change from baseline in GGT, ALT, ALP, AST, total and conjugated bilirubin, GLOBE scores, UK-PBC scores, MELD scores, and noninvasive markers of liver fibrosis, including liver stiffness measured by TE and ELF score;, 4. and percentage of subjects with ALP <1.67 x ULN, total bilirubin ≤ULN, and ALP decrease of ≥15% from baseline., 5. Please refer to the Protocol for detailed Primary end point.
Endpoint(s): 1. Exploratory endpoints include change from baseline in NRS, PBC-40, FIS, and APRI. In addition, time to first occurrence of any of the following:, 2. death (all-cause), liver transplant, MELD score ≥15, hospitalization new onset or recurrence of variceal bleed, hepatic encephalopathy, spontaneous bacterial peritonitis, or hepatocellular carcinoma , portal hypertension syndromes, portal hypertension (clinically evident ascites or endoscopic evidence without bleeding), splenomegaly, and time to first occurrence of each individual component of the composite event endpoint., 3. Please refer to the Protocol for detailed Secondary end point.

Source: https://euclinicaltrials.eu/ctis-public/view/2023-507771-22-01